EU clinical trial 2024-513230-38-00: A Phase 3, Multicenter, Open-Label, Randomized Study of Nemvaleukin Alfa in Combination With Pembrolizumab Versus Investigator’s Choice Chemotherapy in Patients With Platinum-Resistant Epithelial Ovarian, Fallopian Tube, or Primary Peritoneal Cancer (ARTISTRY-7)
Protocol code: ALKS 4230-007
Sponsor: Mural Oncology Inc. (Pharmaceutical company). Phase: Therapeutic confirmatory (Phase III). Countries: Italy (ended), Norway (ended), Spain (ended), France (ended), Denmark (ended), Belgium (ended), Austria (ended), Germany (ended), Czechia (ended), Lithuania (ended).
Therapeutic area(s): Diseases [C] - Neoplasms [C04]
Gender: Female. Age: 18-64 years, 65+ years. Enrolment: 244.
Status: Ended. Start date (EU): 2022-12-15. End date (EU): 2025-05-09. End date: 2025-05-10. Decision date: 2024-09-04. Results received: Yes. Last updated: 2025-02-18.
Decision dates by country: ES: 2024-09-09, DE: 2024-09-12, FR: 2024-09-18, NO: 2024-09-18, CZ: 2024-09-05, LT: 2024-10-03, AT: 2024-09-08, IT: 2024-09-11, BE: 2024-09-04, DK: 2024-09-10

Condition(s): Platinum-Resistant Epithelial Ovarian, Fallopian Tube, or Primary Peritoneal Cancer
Product: TOPOTECAN HYDROCHLORIDE, DOXORUBICIN HYDROCHLORIDE, PACLITAXEL, KEYTRUDA 25 mg/mL concentrate for solution for infusion, NEMVALEUKIN ALFA, GEMCITABINE HYDROCHLORIDE, TOPOTECAN HYDROCHLORIDE

Primary endpoint: Overall survival (OS)
Endpoint(s): 1. Progression-free survival (PFS) as assessed by Investigator, based on Response Evaluation Criteria in Solid Tumors (RECIST) v1.1, 2. Objective response rate (ORR) as assessed by Investigator, based on RECIST v1.1, 3. Disease control rate (DCR), duration of response (DOR), and time to response (TTR) as assessed by Investigator, based on RECIST v1.1, 4. Cancer antigen (CA)-125 response as defined by the Gynecologic Cancer InterGroup (GCIG), 5. Safety as assessed by treatment-emergent adverse events (TEAEs), clinical laboratory parameters, vital signs, and electrocardiograms (ECGs)

Source: https://euclinicaltrials.eu/ctis-public/view/2024-513230-38-00